EU clinical trial 2024-520094-13-00: Plasma cell targeting using the anti-CD38 antibody daratumumab in patients with Myalgic Encephalomyelitis (ME/CFS) – a randomized, placebo-controlled and double-blind phase II study
Protocol code: KTS-11-2024
Sponsor: Helse Bergen HF (Hospital/Clinic/Other health care facility). Phase: Therapeutic exploratory (Phase II). Countries: Norway (ongoing, recruiting).
Therapeutic area(s): Diseases [C] - Immune System Diseases [C20]; Diseases [C] - Nervous System Diseases [C10]
Gender: Female, Male. Age: 18-64 years. Enrolment: 66.
Status: Ongoing, recruiting. Start date (EU): 2025-06-11. Decision date: 2025-05-09. Results received: No. Last updated: 2026-07-17.

Condition(s): Myalgic Encephalomyelitis/Chronic Fatigue Syndrome
Product: Hyaluronidase 1500 I.U. Powder for Solution for Injection/Infusion, DARZALEX 1800 mg solution for injection

Primary endpoint: The course of DSQ-SF total score from baseline through follow-up until week 60.
Endpoint(s): The course of the modified DSQ-SF score from baseline (-12 to 0 weeks) until week 60., The course of SF-36 Physical Function (SF-36 PF), FUNCAP total score and Steps per 24h (calculated as mean values per four-week interval), from baseline (-12 to 0 weeks) until week 60, Overall response, defined as a decrease of 25 points in DSQ-SF score from baseline to the time interval 28 to 48 weeks after start of intervention, Steps per 24 hours, calculated as mean values per four-week interval, from baseline (-12 to 0 weeks) until week 60, Safety and toxicity, recorded continuously through 60 weeks follow-up according to CTCAE ver. 5.0

Source: https://euclinicaltrials.eu/ctis-public/view/2024-520094-13-00